EU clinical trial 2024-512695-34-00: A Phase I/II, Multicenter, Open-Label, Single-Dose, Dose-Ranging Study to Assess the Safety and Tolerability of ST-920, an AAV2/6 Human Alpha Galactosidase A Gene Therapy in Subjects with Fabry Disease.
Protocol code: ST-920-201
Sponsor: Sangamo Therapeutics Inc. (Pharmaceutical company). Phase: Phase I and Phase II (Integrated)- First administration to humans. Countries: Italy (ended), Germany (ended).
Therapeutic area(s): Diseases [C] - Congenital, Hereditary, and Neonatal Diseases and Abnormalities [C16]
Gender: Male. Age: 18-64 years. Enrolment: 8.
Status: Ended. Start date (EU): 2022-06-28. End date (EU): 2025-03-19. End date: 2025-04-10. Decision date: 2024-07-15. Results received: Yes. Last updated: 2024-07-26.
Decision dates by country: DE: 2024-07-26, IT: 2024-07-15

Condition(s): Fabry Disease (X-linked lysosomal storage disease).
Product: ST-920

Primary endpoint: 1. Incidence of treatment-emergent adverse events (TEAEs). Additional safety evaluations will include: o Routine hematology, chemistry, and liver tests, vital signs, electrocardiogram (ECG) and echocardiogram (ECHO). o Serial alpha fetoprotein (AFP) testing and magnetic resonance imaging (MRI) of liver (or equivalent imaging modality) to monitor for liver mass.
Endpoint(s): 1. Change from baseline at specific time points over the 1-year study period in: o α-Gal A activity in plasma o Gb3 and lyso-Gb3 levels in plasma, 2. Change from baseline at specific time points over the 1-year study period in: o Frequency of ERT infusion, 3. Change from baseline at specific time points over the 1-year study period in: o Estimated glomerular filtration rate (eGFR) using the CKD-EPI formula, 4. Change from baseline at specific time points over the 1-year study period in: o Ejection fraction, global longitudinal strain, left ventricular mass index (LVMI), left ventricular systolic function measured by cardiac magnetic resonance imaging (CMR), 5. ST-920 vector clearance measured by level of vector genome in blood (plasma), saliva, urine, stool, and semen (if applicable)

Source: https://euclinicaltrials.eu/ctis-public/view/2024-512695-34-00